EU clinical trial 2024-518212-40-00: Ketamine therapy in obsessive-compulsive disorder and its effects on neuropsychological function under stress in a cross-over trial
Sponsor: Medical University Of Vienna (Educational Institution). Phase: Therapeutic confirmatory (Phase III). Countries: Austria (ongoing, recruiting).
Therapeutic area(s): Psychiatry and Psychology [F] - Mental Disorders [F03]
Gender: Female, Male. Age: 18-64 years. Enrolment: 66.
Status: Ongoing, recruiting. Start date (EU): 2022-08-25. Decision date: 2024-10-29. Results received: No. Last updated: 2025-06-03.

Condition(s): Obsessive Compulsive Disorder (OCD)
Product: Ketamine 50 mg/ml Injection, Midazolam 5 mg/ml, solution for injection / infusion

Primary endpoint: Difference of changes in YBOCS scores before and 7 days after ketamine infusion compared midazolam infusion, tested in an intention to treat set.
Endpoint(s): Difference of changes in OCD-VAS scores between period specific baseline and 24h after ketamine infusion compared to midazolam infusion, tested in a per protocol set., Difference of changes in YBOCS scores between period specific baseline and 24h after ketamine infusion compared to midazolam infusion, tested in a per protocol set., Difference between areas under the curve of OCD-VAS, over the course of 7 days, starting with ketamine and midazolam infusion, respectively, tested in a per protocol set. 5), Difference of changes in neuropsychological function under stress between baseline and 24 hours post ketamine and midazolam infusion, respectively, measured by WCST, SSRT, N-back and ToH, tested in a per protocol set., Difference of changes of hormonal stress response between study baseline and 24 hours post ketamine compared to midazolam infusion, measured by salivary cortisol levels, summarized as an AUC for each period, tested in a per protocol set., Difference of changes of vegetative stress response between study baseline and 24 hours post ketamine compared to midazolam infusion, measured by blood pressure, heart rate and subjective stress VAS scores, summarized as an AUC for each period, tested in a per protocol set., Difference of OCD-VAS scores a month after open-label treatment compared to treatment as usual, tested in a per protocol set., Difference of YBOCS scores a month after open-label treatment compared to treatment as usual, tested in a per protocol set., Distinct changes in EEG frequency bands during ketamine infusion compared to midazolam.

Source: https://euclinicaltrials.eu/ctis-public/view/2024-518212-40-00